EU clinical trial 2024-517881-40-00: RemiRit - Personalized immunosuppressive therapy with rituximab in the treatment of ANCA associated vasculitis - a randomized, multicenter clinical trial
Protocol code: ABM/RemiRit/2021
Sponsor: Wojskowy Instytut Medyczny Panstwowy Instytut Badawczy (Hospital/Clinic/Other health care facility). Phase: Therapeutic exploratory (Phase II). Countries: Poland (ongoing, recruitment ended).
Therapeutic area(s): Diseases [C] - Immune System Diseases [C20]
Gender: Female, Male. Age: 18-64 years, 65+ years. Enrolment: 130.
Status: Ongoing, recruitment ended. Start date (EU): 2022-11-27. Decision date: 2024-11-24. Results received: No. Last updated: 2024-11-24.

Condition(s): Antineutrophil cytoplasmic antibody (ANCA)- associated vasculitis (AAV)
Product: MabThera 1400 mg solution for subcutaneous injection, CYCLOPHOSPHAMIDE, RITUXIMAB

Primary endpoint: Part I induction treatment: The occurrence of complete remission (defined as BVAS/WG=0 disease activity) at 26 weeks after enrollment to Part I. Part II - Maintenance treatment: The occurrence of a positive treatment effect defined as complete remission (BVAS/WG=0 disease activity) or partial remission (BVAS/WG=1 or BVAS/WG=2) at 104 weeks after randomization to Part II.
Endpoint(s): Treatment response defined as a >50% reduction in BVAS/WG vasculitis activity from baseline at 26 weeks after enrollment in Part I., The occurrence of serious adverse events at 26 weeks after enrollment in Part I., The occurence of non-serious adverse events at 26 weeks after enrollment in Part I., The occurence of organ damage (based on VDI) at 26 weeks after enrollment in Part I., Change at 13 and 26 weeks after enrollment in Part I from baseline: a. ANCA autoantibody titre, b. CD19+ lymphocyte count, c. Concentration of C5a component of complement, d. Creatinine concentration, e. eGFR., The occurrence of a major relapse (defined as an increase in BVAS/WG score to ≥3 points, requiring reinitiation of remission-inducing treatment) at 26, 52, 78, and 104 weeks after randomization to Part II., The occurrence of a minor relapse (defined as an increase in BVAS/WG score to 1-2 points, requiring only an increase in maintenance glucocorticosteroid dose) at 26, 52, 78, and 104 weeks after randomization to Part II., The occurrence of serious adverse events at 26, 52, 78, and 104 weeks after randomization to Part II., The occurrence of non-serious adverse events at 26, 52, 78, and 104 weeks from randomization to Part II., The occurrence of organ damage (based on VDI) at 26, 52, 78, and 104 weeks after randomization to Part II., Change at 26, 52, 78, and 104 weeks after randomization to Part II from baseline: a. ANCA autoantibody titers, b. CD 19+ lymphocyte count, c. Concentration of C5a component of complement, d. Creatinine concentration, e. eGFR., Change at 26, 52, 78, and 104 weeks after randomization to Part II from baseline in quality of life as measured by the SF-36 form.

Source: https://euclinicaltrials.eu/ctis-public/view/2024-517881-40-00